EU clinical trial 2024-518739-12-00: DIMREATOX study - Reduction in digestive absorption of toxic substances by combined digestive decontamination in intensive care - randomized single-center study
Protocol code: APHP231308
Sponsor: Assistance Publique Hopitaux De Paris (Hospital/Clinic/Other health care facility). Phase: Therapeutic exploratory (Phase II). Countries: France (ongoing, recruiting).
Therapeutic area(s): Diseases [C] - Digestive System Diseases [C06]
Gender: Female, Male. Age: 18-64 years, 65+ years. Enrolment: 200.
Status: Ongoing, recruiting. Start date (EU): 2026-06-24. Decision date: 2025-07-21. Results received: No. Last updated: 2025-12-19.

Condition(s): Major patients intoxicated by functional toxicant(s), hospitalized in intensive care and intubated.
Product: FORTRANS, poudre pour solution buvable en sachet., TOXICARB, suspension buvable

Primary endpoint: Percentage change in the plasma concentration of the toxic substance(s) (ingested parent molecules) at 24 hours compared with its/their value(s) at randomisation.
Endpoint(s): Percentage change in plasma concentration of toxicant(s) (ingested parent molecules) at H48, H72 and H96 compared with the value at randomisation, Area under the concentration curve up to the 96th hour expressed as a percentage of the concentration at randomisation, Number of days alive without mechanical ventilation for 28 days post-randomisation, Number of days alive without resuscitation for 28 days post-randomisation, Number of episodes of vomiting, Number of ventilator-associated pneumonias, Number of episodes of upper abdominal pain and diarrhoea;, Presence of hypersensitivity reactions such as anaphylactic shock, angioedema, urticaria, rash and pruritus.

Source: https://euclinicaltrials.eu/ctis-public/view/2024-518739-12-00